EU clinical trial 2023-505148-20-00: Kan skattning av njurfunktion (eGFR) förutsäga vilka patienter med S. aureus-bakteremi som behöver justerad dosering via monitorering av kloxacillinkoncentrationer i plasma (TDM)?
Sponsor: Region Oestergoetland (Hospital/Clinic/Other health care facility). Phase: Therapeutic use (Phase IV). Countries: Sweden (ongoing, recruiting).
Therapeutic area(s): Diseases [C] - Bacterial Infections and Mycoses [C01]
Gender: Female, Male. Age: 18-64 years, 65+ years. Enrolment: 90.
Status: Ongoing, recruiting. Start date (EU): 2024-06-01. Decision date: 2023-11-24. Results received: No. Last updated: 2026-06-03.

Condition(s): Staphyloccus aureus bacteremia
Product: CLOXACILLIN

Primary endpoint: Vid mätpunkterna dag 2 och dag 7 efter inklusion: Andel av patienter som når behandlingsmålet 100% ƒT>MIC i relation till njurfunktion samt, Vid mätpunkterna dag 2 och dag 7 efter inklusion: Andel av patienter som når potentiellt toxiska nivåer (fri fraktion > 5 mg/L eller totalkoncentration > 50 mg/L) i relation till njurfunktion
Endpoint(s): Förhöjda nivåer relativt normalpopulationen/referensvärden av någon av urinmarkörerna för tubulär skada (cystatin C, KIM-1, NAG, NGAL och α1-Microglobulin) i relation till koncentrationer (topp och dal) av kloxacillin dag 2 respektive dag 7. Akut njurskada, definierat enligt KDIGO (kreatininbaserat), mätt dagligen 1 - 7., Kliniska tecken på nytillkommen CNS-påverkan (sänkt medvetande mätt med Glasgow coma scale, kramper, konfusion, tremor) mätt dagligen dag 2-7. Skall ställas i relation till kloxacillinkoncentrationer (topp och dal) dag 2 och dag 7., Variabler: kön, ålder, vikt, längd, njurfunktion, samsjuklighet mätt med Charlson comorbidity index, övriga läkemedel (vid inklusion), infektionens allvarlighetsgrad (NEWS), andel komplicerade eller okomplicerad infektioner enligt vedertagna kriterier (IDSA), duration av bakteriemi (dagar) samt 30-dagarsmortalitet, Studiepersonernas upplevelser av deltagande i studien beskrivna i semi-strukterade intervjuer och analyserade med kvalitativa metoder, Nivåer av explorativa biomarkörer i urin och plasma dag 2 och dag 7.

Source: https://euclinicaltrials.eu/ctis-public/view/2023-505148-20-00